EU clinical trial 2023-506760-13-00: A study to investigate the pharmacokinetics of remibrutinib in CSF in healthy participants.
Protocol code: CLOU064C12101
Sponsor: Novartis Pharma AG (Pharmaceutical company). Phase: Human Pharmacology (Phase I)- Other. Countries: Netherlands (ended).
Therapeutic area(s): Diseases [C] - Immune System Diseases [C20]; Diseases [C] - Nervous System Diseases [C10]
Gender: Female, Male. Age: 18-64 years. Enrolment: 16.
Status: Ended. Start date (EU): 2023-12-11. End date (EU): 2024-03-17. Decision date: 2023-11-07. Results received: No. Last updated: 2024-01-17.

Condition(s): Healthy

Source: https://euclinicaltrials.eu/ctis-public/view/2023-506760-13-00